EU clinical trial 2024-511458-32-00: A multicenter study to evaluate the efficacy, safety, tolerability, and pharmacokinetics of filgotinib, with single arm induction and maintenance, in pediatric subjects (8 to <18 years of age) with moderately to severely active ulcerative colitis
Protocol code: GLPG0634-CL-331
Sponsor: Alfasigma S.p.A. (Pharmaceutical company). Phase: Therapeutic confirmatory (Phase III). Countries: France (ongoing, recruiting), Germany (ongoing, recruiting), Belgium (ongoing, recruiting), Romania (authorised, recruiting), Poland (ongoing, recruiting), Ireland (authorised, recruitment pending), Croatia (ongoing, recruiting), Greece (ongoing, recruiting), Portugal (authorised, recruiting), Norway (ongoing, recruiting), Italy (ongoing, recruiting), Spain (authorised, recruiting).
Therapeutic area(s): Diseases [C] - Digestive System Diseases [C06]
Gender: Female, Male. Age: 0-17 years. Enrolment: 68.
Start date (EU): 2025-06-15. Decision date: 2024-11-11. Results received: No. Last updated: 2026-05-29.
Decision dates by country: IE: 2024-11-15, BE: 2024-11-12, RO: 2024-11-18, NO: 2024-11-12, ES: 2024-11-14, DE: 2024-11-13, HR: 2024-11-19, IT: 2024-11-13, GR: 2024-11-11, PL: 2024-11-18, FR: 2024-11-14, PT: 2024-11-12

Condition(s): Ulcerative colitis
Product: GLPG0634, Jyseleca 100 mg film-coated tablets, Jyseleca 200 mg film-coated tablets

Primary endpoint: Proportion of subjects achieving clinical remission based on modified Mayo Clinical Score (mMCS) at Week 10, Proportion of subjects achieving clinical remission based on mMCS2 at Week 58
Endpoint(s): Incidence of treatment-emergent adverse events (TEAEs), adverse events of interest, and laboratory abnormalities through follow-up (Week 62), Change from baseline in body mass index (BMI) at Week 58, Change from baseline in height velocity at Week 58, Proportion of subjects achieving clinical remission defined by Pediatric Ulcerative Colitis Activity Index (PUCAI) <10 at Week 10, Proportion of subjects achieving clinical remission defined by PUCAI <10 at Week 58, Proportion of subjects achieving endoscopic remission defined by Mayo endoscopic subscore of 0 at Week 10, Proportion of subjects achieving endoscopic remission defined by Mayo endoscopic subscore of 0 at Week 58, Proportion of subjects achieving mMCS response defined as mMCS reduction by >=2 points and >=30% from induction baseline, with decrease in rectal bleeding subscore of >=1 or absolute rectal bleeding subscore of 0 or 1 at Week 10, Proportion of subjects achieving MCS response defined as mMCS reduction by >=2 points and >=30% from induction baseline, with decrease in rectal bleeding subscore of >=1 or absolute rectal bleeding subscore of 0 or 1 at Week 58, Proportion of subjects achieving 6-month corticosteroid-free mMCS remission at Week 58, Change from baseline in TUMMY-UC score at Week 10 and Week 58, Proportion of subjects with TUMMY-UC remission at Week 10 and Week 58, Change from baseline in IMPACT-III score at Week 10 and Week 58, PK parameters of filgotinib and its primary metabolite GS-829845 (including maximum observed plasma concentration at steady state [Cmax,ss], area under the plasma concentration-time curve over the dosing interval at steady state [AUC0-24,ss], and area under the plasma concentration-time curve over the dosing interval at steady state for the effective exposure [AUCeff,ss]), Acceptability of the age-appropriate pediatric film-coated tablet formulation assessed by Pediatric Oral Medicine Acceptability Questionnaire for Patients (POMAQ-P), Acceptability of the adult tablet formulation assessed by POMAQ-P

Source: https://euclinicaltrials.eu/ctis-public/view/2024-511458-32-00